EU clinical trial 2025-520573-39-00: Efficiency of a composite personalised care on functional outcome in early psychosis: A Prospective Randomised Controlled Trial
Sponsor: Groupe Hospitalier Universitaire Paris Psychiatrie Et Neuroscience (Hospital/Clinic/Other health care facility). Phase: Therapeutic use (Phase IV). Countries: France (authorised, recruitment pending).
Therapeutic area(s): Psychiatry and Psychology [F] - Mental Disorders [F03]
Gender: Female, Male. Age: 0-17 years, 18-64 years. Enrolment: 500.
Status: Authorised, recruitment pending. Decision date: 2025-01-30. Results received: No. Last updated: 2026-04-30.

Condition(s): Ultra High Risk of psychosis and first episode psychosis
Product: MUCODRILL 600 mg SANS SUCRE, comprimé effervescent édulcoré au sucralose, FOLINORAL 25 mg, gélule, VITAMINE B12 GERDA 250 microgrammes, comprimé sécable, Omacor 1000 mg capsules molles

Primary endpoint: Global functioning will be assessed using the Personal and Social Performance Scale (PSP), determined reference period 3 to 4 months after the begning

Source: https://euclinicaltrials.eu/ctis-public/view/2025-520573-39-00